EU clinical trial 2024-513723-16-00: Prospective, randomized, open, multicenter Phase II trial to investigate the efficacy of trifluridine/tipiracil plus panitumumab versus trifluridine/tipiracil plus bevacizumab as first-line treatment of metastatic colorectal cancer - FIRE-8 - AIO-KRK/YMO-0519
Protocol code: FIRE-8
Sponsor: Charite Universitaetsmedizin Berlin KöR (Hospital/Clinic/Other health care facility). Phase: Therapeutic exploratory (Phase II). Countries: Germany (ongoing, recruiting).
Therapeutic area(s): Diseases [C] - Neoplasms [C04]
Gender: Female, Male. Age: 18-64 years, 65+ years. Enrolment: 153.
Status: Ongoing, recruiting. Start date (EU): 2021-10-21. Decision date: 2024-10-16. Results received: No. Last updated: 2026-04-02.

Condition(s): metastatic colorectal cancer
Product: Lonsurf 15 mg/6.14 mg film-coated tablets, BEVACIZUMAB, Vectibix 20 mg/ml concentrate for solution for infusion, Lonsurf 20 mg/8.19 mg film-coated tablets, BEVACIZUMAB

Primary endpoint: Objective response rate (ORR) according to RECIST 1.1 (assessment at the local trial center)
Endpoint(s): Overall survival (OS), Progression-free survival (PFS), Objective response rate (ORR) according to RECIST 1.1 (assessment by central review), Depth of response (DpR) (assessment by central review), Early tumor shrinkage ([ETS]; assessment by central review), QoL as assessed with the QoL questionnaire EQ-5D-5L, Type, incidence, severity, and causal relationship to IMPs of non-serious adverse events and serious adverse events (severity evaluated according to CTCAE version 5.0), Subsequent anti-tumor treatment lines (monotherapy and combination therapy treatment lines including medicinal products [chemotherapeutics, antibodies and targeted therapy] and investigator reported efficacy of subsequent treatment lines, Identification of biomarker for treatment efficacy and toxicity

Source: https://euclinicaltrials.eu/ctis-public/view/2024-513723-16-00